EU clinical trial 2024-513027-16-00: Phase II multicentric study: efficacy evaluation of neo-adjuvant treatment associated with maintenance therapy by anti-PD1 immunotherapy on disease-free-survival (DFS) in patients with resectable mucosal melanoma (IMMUQ)
Protocol code: 2017/2558
Sponsor: Institut Gustave Roussy (Hospital/Clinic/Other health care facility). Phase: Therapeutic exploratory (Phase II). Countries: France (ongoing, recruitment ended).
Therapeutic area(s): Diseases [C] - Skin and Connective Tissue Diseases [C17]; Diseases [C] - Neoplasms [C04]
Gender: Female, Male. Age: 18-64 years, 65+ years. Enrolment: 60.
Status: Ongoing, recruitment ended. Start date (EU): 2018-05-28. Decision date: 2024-06-26. Results received: No. Last updated: 2025-11-17.

Condition(s): Resectable mucosal melanomas
Product: Lenvatinib, KEYTRUDA 25 mg/mL concentrate for solution for infusion, Lenvatinib

Primary endpoint: Disease free survival, defined as the time between the inclusion in the trial and the date of the first event defined as local, regional, distant relapse or death whatever the cause.
Endpoint(s): Overall survival (OS), Locoregional control (Time to locoregional relapse, TTLRC), Efficacy (Objective response, according to RECIST 1.1), after neoadjuvant therapy, Pathological response after neoadjuvant therapy, Acute toxicity (CTC-NCI V4), Translational criteria o Ex vivo response to anti-PD1 o Prognostic value of biomarkers including PDL1 expression and mutational load o Variation of circulating lymphocytes (before–after treatment)

Source: https://euclinicaltrials.eu/ctis-public/view/2024-513027-16-00